EU clinical trial 2025-521702-18-00: A phase I open-label, multi-center study to evaluate the safety, tolerability, dosimetry, and preliminary activity of [177Lu]Lu-DFC413 and safety and imaging properties of [68Ga]Ga-NNS309 in patients with solid tumors
Protocol code: CGCJ904A12101
Sponsor: Novartis Pharma AG (Pharmaceutical company). Phase: Human Pharmacology (Phase I)- First administration to humans. Countries: Germany (ongoing, recruiting), Portugal (authorised, recruitment pending), France (ongoing, recruiting), Spain (authorised, recruitment pending), Denmark (ongoing, recruiting).
Therapeutic area(s): Diseases [C] - Neoplasms [C04]
Gender: Female, Male. Age: 18-64 years, 65+ years. Enrolment: 62.
Start date (EU): 2026-05-21. Decision date: 2026-02-16. Results received: No. Last updated: 2026-03-23.
Decision dates by country: DK: 2026-02-16, PT: 2026-02-20, DE: 2026-02-19, FR: 2026-02-16, ES: 2026-02-18

Condition(s): Locally advanced unresectable or metastatic colorectal cancer (CRC), Locally advanced unresectable or metastatic pancreatic ductal adenocarcinoma (PDAC), Locally advanced unresectable or metastatic non-small cell lung cancer (NSCLC), Locally advanced unresectable or metastatic soft tissue sarcoma (excluding GIST and Kaposi sarcoma), Locally advanced unresectable or metastatic HR+/HER2- ductal or lobular breast cancer (BC), Locally advanced unresectable or metastatic triple negative breast cancer (TNBC)

Source: https://euclinicaltrials.eu/ctis-public/view/2025-521702-18-00